EU clinical trial 2023-503481-23-00: Maintenance Pembrolizumab at Usual or Low doSE in non-squamous lung cancer: a non-inferiority study
Protocol code: 2021/3336
Sponsor: Institut Gustave Roussy (Hospital/Clinic/Other health care facility). Phase: Therapeutic confirmatory (Phase III). Countries: France (ongoing, recruiting), Spain (ongoing, recruiting), Belgium (ongoing, recruiting).
Therapeutic area(s): Diseases [C] - Respiratory Tract Diseases [C08]; Analytical, Diagnostic and Therapeutic Techniques and Equipment [E] - Therapeutics [E02]
Gender: Female, Male. Age: 18-64 years, 65+ years. Enrolment: 1666.
Status: Ongoing, recruiting. Start date (EU): 2023-03-20. Decision date: 2024-03-12. Results received: No. Last updated: 2025-03-06.
Decision dates by country: FR: 2024-03-12, ES: 2024-12-23, BE: 2025-02-27

Condition(s): Maintenance treatment in metastatic non-squamous lung cancer

Source: https://euclinicaltrials.eu/ctis-public/view/2023-503481-23-00